EU clinical trial 2023-508325-27-00: NAPO - Novel Approach for Oligospermia
Sponsor: Herlev Hospital (Hospital/Clinic/Other health care facility). Phase: Therapeutic exploratory (Phase II). Countries: Denmark (ended).
Therapeutic area(s): Diseases [C] - Male Urogenital Diseases [C12]
Gender: Male. Age: 18-64 years. Enrolment: 60.
Status: Ended. Start date (EU): 2024-04-01. End date (EU): 2025-01-27. Decision date: 2023-12-19. Results received: Yes. Last updated: 2023-12-19.

Condition(s): Male infertility
Product: SALINE, Prolia 60 mg solution for injection in pre-filled syringe

Primary endpoint: Difference in sperm cell concentration (sperm cell concentration millions/mL) between the two groups, evaluted by the semen sample delivered at day 80
Endpoint(s): Difference in semen quality between the intervention group and the placebo group (total number of sperm cells, and total and percentage of motile, progressive motile and morphological normal sperm cells), evaluated by semen sample delivered at day 80 compared with baseline, Difference in spontaneous pregnancies before day 180, Difference in number of spontaneous abortions during the whole trial, Difference in serum levels of reproductive hormones (FSH, LH, AMH, Inhibin B) at day 80, Changes in serum levels of reproductive hormones (FSH, LH, AMH, Inhibin B) at day 80 within the groups

Source: https://euclinicaltrials.eu/ctis-public/view/2023-508325-27-00